EU clinical trial 2022-502216-36-00: Study of exposure to substances prohibited by the World Anti-Doping Agency in healthy volunteers. Proof of concept.
Protocol code: IMIMFTCL/ESPAMA_2
Sponsor: Municipal Institute Of Medical Investigation, Hospital Del Mar (Laboratory/Research/Testing facility, Hospital/Clinic/Other health care facility). Phase: Human Pharmacology (Phase I)- Other. Countries: Spain (ended).
Therapeutic area(s): Analytical, Diagnostic and Therapeutic Techniques and Equipment [E] - Investigative Techniques [E05]
Gender: Male. Age: 18-64 years. Enrolment: 28.
Status: Ended. Start date (EU): 2023-02-27. End date (EU): 2024-10-16. Decision date: 2023-02-13. Results received: No. Last updated: 2024-02-26.

Condition(s): Healthy volunteers

Source: https://euclinicaltrials.eu/ctis-public/view/2022-502216-36-00